EU clinical trial 2023-507193-40-00: A Multicenter, Randomized, Double-Blind, Placebo and Active Comparator Controlled Phase 3 Study to Evaluate the Efficacy and Safety of ESK-001 in Patients with Moderate to Severe Plaque Psoriasis (ONWARD1)
Protocol code: ESK-001-016
Sponsor: Alumis Inc. (Laboratory/Research/Testing facility). Phase: Therapeutic confirmatory (Phase III). Countries: Bulgaria (ended), Belgium (ended), Portugal (ended), Poland (ended), Czechia (ended), Germany (ended).
Therapeutic area(s): Diseases [C] - Skin and Connective Tissue Diseases [C17]
Gender: Female, Male. Age: 18-64 years, 65+ years. Enrolment: 681.
Status: Ended. Start date (EU): 2025-01-16. End date (EU): 2025-11-20. End date: 2026-02-11. Decision date: 2024-12-10. Results received: No. Last updated: 2025-12-10.
Decision dates by country: BE: 2024-12-10, PT: 2024-12-11, CZ: 2024-12-11, BG: 2024-12-16, DE: 2024-12-10, PL: 2024-12-16

Condition(s): Moderate to Severe Plaque Psoriasis
Product: ESK-001, Otezla 30 mg film-coated tablets, Otezla 10mg, 20mg, 30 mg film-coated tablets, Name: ESK-001 placebo Pharmaceutical Form: film-coated tablet; Route of administration: Oral use Maximum duration of treatment: 16 weeks, Name: apremilast placebo Pharmaceutical form: Only over-encapsulating capsule shell containing backfill, no tablet Route of administration: oral use Maximum duration of treatment: 16 weeks, Otezla 30 mg film-coated tablets

Primary endpoint: The proportion of patients who achieve co-primary endpoint (PASI-75 & sPGA-0/1) at Week 16 compared with Placebo
Endpoint(s): Week 16 Endpoints: *The proportion of patients who achieve PASI-90, PASI-100, sPGA-0 PASI-75 and sPGA-0/1 compared to apremilast ss-PGA-0/1 PROs: PSSD-0 and DLQI-0/1 *Change from baseline in %BSA Pruritis NRS score, Week 24 Endpoints compared to apremilast: *The proportion of patients who achieve PASI-75, PASI-90, PASI-100 sPGA-0/1, sPGA-0 ss-PGA-0/1 PROs: PSSD-0 and DLQI-0/1 *Change from baseline %BSA Pruritis NRS score

Source: https://euclinicaltrials.eu/ctis-public/view/2023-507193-40-00